EU clinical trial 2023-510251-31-00: A phase II study on adjuvant vaccination with dendritic cells loaded with autologous tumor homogenate in resected stage IV rare cancers: neuroendocrine tumors (NET) and soft tissue sarcoma (STS).
Protocol code: IRST100.42
Sponsor: Istituto Romagnolo Per Lo Studio Dei Tumori Dino Amadori IRST S.r.l. (Hospital/Clinic/Other health care facility). Phase: Therapeutic exploratory (Phase II). Countries: Italy (ongoing, recruiting).
Therapeutic area(s): Diseases [C] - Neoplasms [C04]
Gender: Female, Male. Age: 18-64 years, 65+ years. Enrolment: 30.
Status: Ongoing, recruiting. Start date (EU): 2019-12-12. Decision date: 2024-07-17. Results received: No. Last updated: 2024-07-17.

Condition(s): neuroendocrine tumors, soft tissue sarcoma
Product: Proleukin 18 x 106 UI Polvere per soluzione iniettabile o per infusione, DC-VACCINE_IRSTIRCCS

Primary endpoint: Proportion of patients experiencing grade 3 or higher adverse events, Number of patients showing enhancement in the proportion of circulating immune effectors specific for a selected panel of associated antigens for each disease
Endpoint(s): Overall survival; relapse-free survival, Proportion of patients with positive DHT test will be calculated and the predictive role will be analyzed taking account of the relationship with the primary and the other secondary outcomes, All the immunological objectives will be calculated in terms of proportion and the correlation with efficacy and safety parameters will be explored

Source: https://euclinicaltrials.eu/ctis-public/view/2023-510251-31-00